EU clinical trial 2023-507149-27-00: PROCLAIM: A Phase 3 Randomized Placebo-controlled Double-blind Study of Romiplostim for the Treatment of Chemotherapy-induced Thrombocytopenia in Patients Receiving Chemotherapy for Treatment of Non-small Cell Lung Cancer (NSCLC), Ovarian Cancer, or Breast Cancer
Protocol code: 20170770
Sponsor: Amgen Inc. (Pharmaceutical company). Phase: Therapeutic confirmatory (Phase III). Countries: Greece (ongoing, recruitment ended), Portugal (ended), Romania (ongoing, recruitment ended), Poland (ongoing, recruitment ended), Spain (ongoing, recruitment ended).
Therapeutic area(s): Diseases [C] - Neoplasms [C04]
Gender: Female, Male. Age: 18-64 years, 65+ years. Enrolment: 46.
Start date (EU): 2019-11-04. Decision date: 2024-04-17. Results received: No. Last updated: 2026-06-10.
Decision dates by country: PT: 2024-04-18, PL: 2024-04-29, ES: 2024-04-17, RO: 2024-04-22, GR: 2024-06-03

Condition(s): Chemotherapy-induced Thrombocytopenia in Adult subjects with Non-small Cell Lung Cancer (NSCLC), Ovarian Cancer, or Breast Cancer
Product: Nplate 500 micrograms powder for solution for injection, Placebo will be provided in identical 5 mL single-use vials as a sterile, white, preservative-free, lyophilized powder containing histidine, mannitol, sucrose, and polysorbate 20 and has a pH 5.0 when reconstituted with sterile water for injection., Nplate 500 micrograms powder for solution for injection

Primary endpoint: Incidence of either a chemotherapy dose delay or reduction No thrombocytopenia-induced modification of any myelosuppressive agent in the second and third cycles of the planned on-study chemotherapy regimen. Thrombocytopenia-induced modifications include chemotherapy dose reduction, delay, omission, or chemotherapy treatment discontinuation due to platelet counts below 100 x 109/L Time Frame: 48 days
Endpoint(s): Depth of Platelet Count the depth of the platelet count nadir from the start of the first on-study chemotherapy cycle through the end of the treatment period Time Frame: 48 days, Time to First platelet response The time to first platelet response, defined by platelet count ≥ 100 x 109/L in the absence of platelet transfusions during the preceding 7 days. Time Frame: 7 days, the duration-adjusted event rate of ≥ grade 2 bleeding events the duration-adjusted event rate of ≥ grade 2 bleeding events, as assessed by Common Terminology Criteria for Adverse Events (CTCAE) version 5.0 grading scale. Time Frame: 48 days, Overall survival 1-year overall survival Time Frame: 1 year, Proportion of subjects with at least 1 incidence of platelet transfusion platelet transfusion(s) during the treatment period Time Frame: 48 days, Proportion of patients achieving platelet count >= 100 x 10 9/L 7 days after 3rd dose of IP with no transfusions in preceding 7 days Time Frame: 7 days, The subject incidence of adverse events Through end of study, up to 36 months. It will be counted in as an adverse event: any treatment - emergent adverse events, fatal adverse events, serious adverse events, or clinically significant changes in laboratory values. Time Frame: 36 months, Number of subjects who develop anti-romiplostim antibodies Through end of study up to 36 months Time Frame: 36 months, Number of subjects who develop anti-TPO antibodies Through end of study, up to 36 months Time Frame: 36 months, Number of subjects who experience myelodysplastic syndromes Through end of study, up to 36 months Time Frame: 36 months, Number of subjects who experience secondary malignancies Through end of study, up to 36 months Time Frame: 36 months

Source: https://euclinicaltrials.eu/ctis-public/view/2023-507149-27-00